EU clinical trial 2024-515311-22-00: ATOMYELO: Phase I study with dose-escalation and expansion evaluating the safety and efficacy of oral Arsenic (ATO) in low-risk Myelodysplastic Syndromes failing Erythropoiesis Stimulating Agents and Luspatercept (or ineligible for the latter)
Protocol code: ATOMYELO
Sponsor: Groupe Francophone Des Myelodysplasies (Patient organisation/association). Phase: Human Pharmacology (Phase I)- Other. Countries: France (ongoing, recruiting).
Therapeutic area(s): Diseases [C] - Hemic and Lymphatic Diseases [C15]
Gender: Female, Male. Age: 18-64 years, 65+ years. Enrolment: 24.
Status: Ongoing, recruiting. Start date (EU): 2025-07-22. Decision date: 2025-02-21. Results received: No. Last updated: 2025-08-14.

Condition(s): low-risk Myelodysplastic Syndromes failing Erythropoiesis Stimulating Agents and Luspatercept (or ineligible for the latter)
Product: Arsenic Trioxide gélules 1 mg, Arsenic Trioxide gélules 3 mg, Arsenic Trioxide gélules 5 mg

Primary endpoint: Part 1 (Phase I study): Dose-limiting toxicity (DLT) of oral ATO over an observation period from day 28 to day 42 following the start of cycle 1, Part II (Expansion Phase): Erythroid response rate (HI-E) after 12 weeks oral ATO treatment
Endpoint(s): Safety profile and tolerability measured according to CTCAE (latest version), Bioequivalence compared to IV ATO in terms of PK/PD, Response to treatment will be assessed after cycle 3 according to IWG 2018 criteria, Response duration measured from date of objective response to date of relapse or progression (or date of last news in absence of event), Rate and time to transformation to high-risk MDS or AML, Progression-free survival, Overall survival from date of inclusion to death or date of last news, Exploratory criteria: factors associated with survival and response, including IPSS-R, karyotype and somatic mutations (IPSS-M)

Source: https://euclinicaltrials.eu/ctis-public/view/2024-515311-22-00